EU clinical trial 2024-516649-38-00: Randomized phase III trial on NIraparib-Dostarlimab) vs physician’s choice CHEmotherapy in recurrent, ovarian, fallopian tube or primary peritoneal cancer patients not candidate for platinum retreatment: NItCHE trial (MITO 33)
Protocol code: MITO 33
Sponsor: Fondazione Policlinico Universitario Agostino Gemelli IRCCS (Hospital/Clinic/Other health care facility). Phase: Therapeutic confirmatory (Phase III). Countries: Italy (ongoing, recruiting), Czechia (ongoing, recruiting), Germany (ongoing, recruiting), France (ongoing, recruiting).
Therapeutic area(s): Diseases [C] - Neoplasms [C04]
Gender: Female. Age: 18-64 years, 65+ years. Enrolment: 427.
Status: Ongoing, recruiting. Start date (EU): 2020-12-01. Decision date: 2024-11-12. Results received: No. Last updated: 2026-02-20.
Decision dates by country: FR: 2024-11-13, DE: 2024-11-15, IT: 2024-11-20, CZ: 2024-11-12

Condition(s): Recurrent ovarian, fallopian tube or primary peritoneal cancer
Product: TOPOTECAN, DOSTARLIMAB, BEVACIZUMAB, PACLITAXEL, NIRAPARIB, DOXORUBICIN, GEMCITABINE

Primary endpoint: Overall Survival (OS), defined as the time from randomization to the date of death by any cause

Source: https://euclinicaltrials.eu/ctis-public/view/2024-516649-38-00